EU clinical trial 2025-520996-16-00: A single-center pilot study to establish a novel hypoglycemic clamp procedure to assess the time to spontaneous recovery from hypoglycemia in people with and without diabetes
Sponsor: Medical University Of Graz (Educational Institution). Phase: Phase I and Phase II (Integrated)- Other. Countries: Austria (ended).
Therapeutic area(s): Diseases [C] - Nutritional and Metabolic Diseases [C18]; Diseases [C] - Hormonal diseases [C19]
Gender: Female, Male. Age: 18-64 years. Enrolment: 24.
Status: Ended. Start date (EU): 2025-07-02. End date (EU): 2025-11-07. Decision date: 2025-06-11. Results received: No. Last updated: 2025-06-11.

Condition(s): Type 2 Diabetes Mellitus
Product: NovoRapid 100 units/ml solution for injection in vial

Primary endpoint: Ratio of insulin rates (mU/kg/min) required to lower PG from 90 – 70 mg/dL within 90 min (±30 min) and insulin rates required to lower PG from 70 – 48 mg/dL within 90 min (±30 min)
Endpoint(s): Comparison of the ratio of insulin rates derived in participants with diabetes versus the ratio of insulin rates derived in participants without diabetes, Comparison of the total insulin amount (mU/kg) required to achieve nadir (PG 48 mg/dL [2.7 mmol/L]) at the first clamp visit versus at the second clamp visit, Comparison of the total insulin amount (mU/kg) required to achieve nadir (PG 48 mg/dL [2.7 mmol/L]) in participants with versus participants without diabetes, Number of participants who achieved spontaneous recovery from hypoglycemia, Number of participants who did not reach nadir (PG 48 mg/dL [2.7 mmol/L]), Number of participants who did not spontaneously recovered after reaching nadir, Time to spontaneous recovery from hypoglycemia, Glucose i.v. (mg/kg) administered within the first 30 minutes after reaching nadir (PG 48 mg/dL [2.7 mmol/L]), Rescue glucose i.v. (mg/kg) administered from 31 – 60 minutes after reaching nadir (PG 48 mg/dL [2.7 mmol/L])

Source: https://euclinicaltrials.eu/ctis-public/view/2025-520996-16-00